EU clinical trial 2025-524368-39-00: The effect op corticosteroids on quality of life following total hip arthroplasty: HIPSTER study
Sponsor: Ziekenhuis Oost Limburg (Hospital/Clinic/Other health care facility). Phase: Therapeutic use (Phase IV). Countries: Belgium (ongoing, recruiting).
Therapeutic area(s): Analytical, Diagnostic and Therapeutic Techniques and Equipment [E] - Anesthesia and Analgesia [E03]
Gender: Female, Male. Age: 18-64 years, 65+ years. Enrolment: 224.
Status: Ongoing, recruiting. Start date (EU): 2026-01-30. Decision date: 2026-01-21. Results received: No. Last updated: 2026-01-21.

Condition(s): Patients aged 60 years or older undergoing total hip arthroplasty
Product: Aacidexam 5 mg/ml solution injectable, Aacidexam 5 mg/ml oplossing voor injectie

Primary endpoint: Health-related quality of life (EQ-5D-5L) on day 30, 60 and 90 following surgery
Endpoint(s): Quality of recovery (QoR-15) on day 1, day 3, and day 5 following surgery, Health-related quality of life (EQ-VAS) on day 30, 60 and 90 following surgery, Oxford Hip Score (OHS) on day 30, 60 and 90 following surgery, Brief Pain Inventory (BPI) on day 30, 60 and 90 following surgery, Chalder fatigue questionnaire (CFQ) on day 30, 60 and 90 following surgery

Source: https://euclinicaltrials.eu/ctis-public/view/2025-524368-39-00